EU clinical trial 2023-503912-34-00: L-NAC for reversal of opioid-induced respiratory depression
Sponsor: Leiden University Medical Center (Hospital/Clinic/Other health care facility). Phase: Phase III and phase IV (Integrated). Countries: Netherlands (ended).
Therapeutic area(s): Phenomena and Processes [G] - Physiological processes [G07]; Analytical, Diagnostic and Therapeutic Techniques and Equipment [E] - Anesthesia and Analgesia [E03]
Gender: Female, Male. Age: 18-64 years. Enrolment: 18.
Status: Ended. Start date (EU): 2023-07-19. End date (EU): 2024-09-09. Decision date: 2023-05-12. Results received: Yes. Last updated: 2024-04-22.

Condition(s): none, healthy subjects only
Product: Fentanyl hameln 50 microgram/ml, oplossing voor injectie, Fluimucil 200 mg/ml concentraat voor oplossing voor infusie, 0.9% NaCl solution for infusion, Naloxone 400 micrograms/ml solution for injection/infusion

Primary endpoint: Minute ventilation
Endpoint(s): End-tidal carbon dioxide partial pressure, Respiratory frequency, Tidal volume, Arterial blood gas analyses, Blood plasma concentrations of fentanyl and L-NAC

Source: https://euclinicaltrials.eu/ctis-public/view/2023-503912-34-00